EU clinical trial 2022-502746-27-00: A Randomised, Multicentre, Double-blind, Placebo-controlled, Phase III Study of First-line Carboplatin and Paclitaxel in Combination with Durvalumab, Followed by Maintenance Durvalumab with or without Olaparib in Patients with Newly Diagnosed Advanced or Recurrent Endometrial Cancer (DUO-E)
Protocol code: D9311C00001
Sponsor: AstraZeneca AB (Pharmaceutical company). Phase: Therapeutic confirmatory (Phase III). Countries: Belgium (ongoing, recruitment ended), Lithuania (ongoing, recruitment ended), Estonia (ongoing, recruitment ended), Germany (ongoing, recruitment ended), Spain (ongoing, recruitment ended), Hungary (ongoing, recruitment ended), Greece (ongoing, recruitment ended), Poland (ongoing, recruitment ended).
Therapeutic area(s): Diseases [C] - Neoplasms [C04]
Gender: Female. Age: 18-64 years, 65+ years. Enrolment: 116.
Status: Ongoing, recruitment ended. Start date (EU): 2020-08-21. Decision date: 2024-08-22. Results received: No. Last updated: 2026-07-20.
Decision dates by country: EE: 2024-08-23, PL: 2024-10-05, LT: 2024-09-06, BE: 2024-08-22, HU: 2024-08-27, GR: 2024-10-11, ES: 2024-08-26, DE: 2024-08-29

Condition(s): Endometrial Cancer
Product: Lynparza 100 mg film-coated tablets, Flixabi 100 mg powder for concentrate for solution for infusion, Myfenax 250 mg hard capsules, Flixabi 100 mg powder for concentrate for solution for infusion, Lynparza 150 mg film-coated tablets, Flixabi 100 mg powder for concentrate for solution for infusion, Myfenax 250 mg hard capsules, IMFINZI 50 mg/mL concentrate for solution for infusion., Flixabi 100 mg powder for concentrate for solution for infusion, Lynparza 100 mg, Lynparza 150 mg, Myfenax 250 mg hard capsules, Imfinzi 50 mg/ml, Flixabi 100 mg powder for concentrate for solution for infusion, Myfenax 250 mg hard capsules

Primary endpoint: PFS (per RECIST 1.1 as assessed by investigator) is defined as the time from randomisation until the date of objective disease progression or death (by any cause in the absence of progression).
Endpoint(s): PFS2: Second progression-free survival is defined as the time from randomisation to the earliest of progression event subsequent to first subsequent therapy (assessed by the investigator per local standard clinical practice and may involve any of the following: objective radiological imaging, symptomatic progression), or death due to any cause., OS: Overall survival is defined as the time from the date of randomisation until death due to any cause., ORR: Objective response rate is the proportion of patients with measurable disease at baseline who have confirmed complete response (CR) or partial response (PR), as determined by the investigator at local site., DoR: Duration of response is time from the date of first documented response (subsequently confirmed) until date of documented progression or death in the absence of disease progression, as determined by the investigator at local site., TFST: Time to first subsequent therapy or death is time from randomisation to the earlier of start date of the first subsequent anticancer therapy after discontinuation of randomised treatment or death due to any cause., TSST: Time to second subsequent therapy or death is time from randomisation to the earlier of start date of the second subsequent anticancer therapy after discontinuation of first subsequent treatment or death due to any cause., TDT: Time to study treatment discontinuation or death is time from randomisation to the earlier of the date of study treatment discontinuation or death., Serum concentrations of durvalumab, Anti-drug antibodies (ADA) to durvalumab, Safety and tolerability will be evaluated in terms of AEs/serious AEs (SAEs), physical examination, vital signs including blood pressure, pulse, clinical laboratory including clinical chemistry/haematology parameters, and ECG

Source: https://euclinicaltrials.eu/ctis-public/view/2022-502746-27-00